EU clinical trial 2024-515661-34-00: Effect of pharmacological treatment with angiotensin receptor/neprilysin inhibitors on transthyretin cardiac amyloidosis and heart failure with reduced ejection fraction (SAVA-TTR trial)
Sponsor: Fundacion Para La Investigacion Biomedica Del Hospital Universitario Puerta De Hierro Majadahonda (Patient organisation/association). Phase: Therapeutic use (Phase IV). Countries: Spain (ongoing, recruiting).
Therapeutic area(s): Diseases [C] - Cardiovascular Diseases [C14]
Gender: Female, Male. Age: 18-64 years, 65+ years. Enrolment: 114.
Status: Ongoing, recruiting. Start date (EU): 2025-02-27. Decision date: 2024-10-24. Results received: No. Last updated: 2026-04-13.

Condition(s): Transthyretin cardiac amyloidosis
Product: Entresto 24 mg/26 mg film-coated tablets

Primary endpoint: Change in left ventricular ejection fraction (%), assessed by echocardiogram, compared to baseline value after 12-month treatment with Sacubitrl/Valsartan versus management without Sacubitril/Valsartan. An improvement in left ventricular ejection fraction will be defined as an increase of ≥ 5% between the baseline echocardiogram and the 12-month echocardiogram.

Source: https://euclinicaltrials.eu/ctis-public/view/2024-515661-34-00